EU clinical trial 2023-504832-16-00: A Randomized, Open-Label, Multicenter, Global, Phase 2 Trial to Evaluate the Efficacy and Safety of Epcoritamab (GEN3013; DuoBody®-CD3×CD20) as Monotherapy or in Combination with Lenalidomide as First-Line Therapy for Anthracycline-Ineligible Subjects with Diffuse Large B-Cell Lymphoma
Sponsor: Genmab A/S (Pharmaceutical company). Phase: Therapeutic exploratory (Phase II). Countries: Belgium (ended), Czechia (ended), France (ended), Germany (ended), Austria (ended), Poland (ended), Italy (ended), Spain (ended).
Therapeutic area(s): Diseases [C] - Neoplasms [C04]
Gender: Female, Male. Age: 65+ years. Enrolment: 102.
Status: Ended. Start date (EU): 2023-01-24. End date (EU): 2026-06-10. End date: 2026-06-10. Decision date: 2024-01-18. Results received: No. Last updated: 2026-03-30.
Decision dates by country: AT: 2024-01-22, PL: 2024-01-31, FR: 2024-01-22, BE: 2024-01-29, CZ: 2024-01-18, DE: 2024-01-26, IT: 2024-02-05, ES: 2024-01-18

Condition(s): DIFFUSE LARGE B CELL LYMPHOMA
Product: Epcoritamab, Epcoritamab, PARACETAMOL, ANAKINRA, LENALIDOMIDE, DEXAMETHASONE, DIPHENHYDRAMINE, SILTUXIMAB, TOCILIZUMAB

Primary endpoint: Complete response (CR) rate determined by Lugano criteria
Endpoint(s): Duration of response (DOR) determined by Lugano criteria, Duration of complete response (DOCR) determined by Lugano criteria, Time to response (TTR) determined by Lugano criteria, Overall response rate (ORR) determined by Lugano criteria, Progression-free survival (PFS) determined by Lugano criteria, Time to next (anti-lymphoma) therapy (TTNT)., Rate and duration of minimal residual disease (MRD) negative status, Overall survival (OS), Incidence of dose-limiting toxicities (DLTs), Incidence and severity of adverse events (AEs), Incidence and severity of changes in laboratory values, Incidence of antidrug antibodies (ADAs) to epcoritamab, PK parameters (clearance, volume of distribution, area under-the- concentration-time curve [AUC0-last and AUC0-∞], maximum concentration [Cmax], time of Cmax [Tmax], predose values, and halflife [t½]), Changes in lymphoma symptoms as measured by the Functional Assessment of Cancer Therapy – Lymphoma (FACT-Lym)

Source: https://euclinicaltrials.eu/ctis-public/view/2023-504832-16-00